EU clinical trial 2024-517864-49-01: Metformin versus Tolvaptan in adults with Autosomal Dominant Polycystic Kidney Disease (ADPKD): a phase 3a, independent, multi- centre, 2 parallel arms randomized controlled trial
Protocol code: AIFA-2016-02365060
Sponsor: University Of Bari Aldo Moro (Educational Institution). Phase: Therapeutic confirmatory (Phase III). Countries: Italy (ongoing, recruiting).
Therapeutic area(s): Diseases [C] - Congenital, Hereditary, and Neonatal Diseases and Abnormalities [C16]
Gender: Female, Male. Age: 18-64 years. Enrolment: 150.
Status: Ongoing, recruiting. Start date (EU): 2020-09-08. Decision date: 2025-01-21. Results received: No. Last updated: 2026-03-10.

Condition(s): Autosomal Dominant Polycystic Kidney Disease
Product: Jinarc 15 mg tablets + Jinarc 45 mg tablets, Jinarc 30 mg tablets + Jinarc 90 mg tablets, Jinarc 30 mg tablets + Jinarc 60 mg tablets, METFORMIN

Primary endpoint: Primary outcome of the study is to evaluate the treatments difference (between Metformin and Tolvaptan) in annualized slope of eGFR (CKD-epi) for individual subjects will be calculated using an appropriate baseline and post-randomization assessment
Endpoint(s): The key secondary endpoint is the percent change from baseline in htTKV as measured by CT-scan at 12 and 24 months.

Source: https://euclinicaltrials.eu/ctis-public/view/2024-517864-49-01